EU clinical trial 2022-500115-39-00: A Phase 1, Open-Label, Dose-Escalation and Dose-Expansion Study to Evaluate the Safety, Tolerability, Pharmacokinetics, and Antitumor Activity of ADCT-901 as Monotherapy in Patients with Selected Advanced Solid Tumors
Protocol code: ADCT-901-101
Sponsor: ADC Therapeutics S.A. (Pharmaceutical company). Phase: Human Pharmacology (Phase I)- First administration to humans. Countries: Spain (ended).
Therapeutic area(s): Diseases [C] - Neoplasms [C04]
Gender: Female, Male. Age: 18-64 years, 65+ years. Enrolment: 50.
Status: Ended. Start date (EU): 2022-12-23. End date (EU): 2024-02-22. End date: 2024-09-10. Decision date: 2022-07-18. Results received: No. Last updated: 2023-12-18.
Decision dates by country: ES: 2022-09-29

Condition(s): Advanced Solid Tumors

Source: https://euclinicaltrials.eu/ctis-public/view/2022-500115-39-00